EU clinical trial 2025-521729-33-00: C5951001- A Phase 1 Study of PF-08046876 in Participants with Advanced Solid Tumors.
Protocol code: C5951001
Sponsor: Pfizer Inc. (Pharmaceutical company). Phase: Human Pharmacology (Phase I)- First administration to humans. Countries: Spain (ongoing, recruiting).
Therapeutic area(s): Diseases [C] - Neoplasms [C04]
Gender: Female, Male. Age: 18-64 years, 65+ years. Enrolment: 70.
Status: Ongoing, recruiting. Start date (EU): 2026-02-10. Decision date: 2025-12-23. Results received: No. Last updated: 2025-12-23.

Condition(s): advanced solid tumors

Source: https://euclinicaltrials.eu/ctis-public/view/2025-521729-33-00